EU clinical trial 2024-516614-37-00: Safety and efficacy of allogenic adipose tissue-derived mesenchymal stromal cells in patients with epidermolysis bullosa: Clinical trial phase I/II
Sponsor: Masarykova Univerzita (Educational Institution). Phase: Phase I and Phase II (Integrated)- Other. Countries: Czechia (ended).
Therapeutic area(s): Diseases [C] - Congenital, Hereditary, and Neonatal Diseases and Abnormalities [C16]
Gender: Female, Male. Age: 0-17 years, 18-64 years. Enrolment: 8.
Status: Ended. Start date (EU): 2022-10-12. End date (EU): 2025-07-22. Decision date: 2024-11-11. Results received: No. Last updated: 2025-07-14.

Condition(s): Epidermolysis bullosa congenita
Product: Allogeneic adipose tissue-derived mesenchymal stromal cells

Primary endpoint: Incidence of adverse events of special interest (AESI): severe local reaction at the injection site other than blistering, severe systemic allergic reaction at any time after MSC administration, severe systemic or local infectious complications at any time after MSC administration (combined primary safety endpoint)
Endpoint(s): Incidence, type, seriousness, intensity of AEs and their relation to study medication, Percent change in the non-healed area of the area marked in the study active and control lesions from baseline, Estimation of the total area of lesions on the patient's body (% of body surface area), Patient-reported outcomes (itching, ease of wound dressing change)

Source: https://euclinicaltrials.eu/ctis-public/view/2024-516614-37-00